EU clinical trial 2024-514954-63-00: PLATFORM - A PLATFORM TRIAL, EVALUATING NEW DRUGS OR COMBINATION IN RELAPSED OR REFRACTORY PERIPHERAL T-CELL LYMPHOMAS
Protocol code: PLATFORM
Sponsor: LYSARC (Laboratory/Research/Testing facility). Phase: Phase I and Phase II (Integrated)- Other. Countries: France (ongoing, recruiting).
Therapeutic area(s): Diseases [C] - Hemic and Lymphatic Diseases [C15]
Gender: Female, Male. Age: 18-64 years, 65+ years. Enrolment: 80.
Status: Ongoing, recruiting. Start date (EU): 2025-08-20. Decision date: 2025-06-03. Results received: No. Last updated: 2026-07-30.
Decision dates by country: FR: 2025-06-18

Condition(s): RELAPSED OR REFRACTORY PERIPHERAL T-CELL LYMPHOMAS
Product: AZACITIDINE, IOA-244, Onureg 200 mg film coated tablets, Venclyxto 100 mg film-coated tablets, Golcadomide, Golcadomide

Primary endpoint: Phase 1: maximum tolerated dose (MTD) and the recommended phase II dose. Assessment of the MTD will be performed by the analysis of the dose-limiting toxicities (DLTs)., Phase 2: Modified Progression-Free Survival (mPFS), defined as time from first dose of sub-study treatment until one of the following events occurs, whichever comes first: a) Disease progression (PD) b) Relapse after achievement of CR or PR c) Administration of any additional unplanned anti-lymphoma treatment (except allogeneic or autologous hematopoietic cell transplantations used as consolidation treatment) d) Death due to any cause.
Endpoint(s): - Objective response rate (ORR), - Complete response rate (CRR), - Clinical benefit rate (CBR), - Best Objective response (BOR), - Progression free survival (PFS), - Lymphoma specific survival (LSS), - Duration of Response (DoR), - Time to next treatment or death (TNT-D), - Overall Survival (OS), - Rate of transplantation following treatment, - Time to transplantation, - Safety

Source: https://euclinicaltrials.eu/ctis-public/view/2024-514954-63-00